EU clinical trial 2023-507131-38-00: A Multicenter, Open-Label Extension Study to Evaluate the Long-Term Safety and Tolerability of the Port Delivery System with Ranibizumab in Patients with Neovascular Age-Related Macular Degeneration
Protocol code: GR40549
Sponsor: F. Hoffmann-La Roche AG (Pharmaceutical company). Phase: Therapeutic confirmatory (Phase III). Countries: Italy (ongoing, recruiting), Belgium (ended), Spain (ongoing, recruiting), Germany (ongoing, recruiting), Austria (ongoing, recruiting), France (ongoing, recruiting).
Therapeutic area(s): Diseases [C] - Eye Diseases [C11]
Gender: Female, Male. Age: 18-64 years, 65+ years. Enrolment: 191.
Start date (EU): 2022-05-16. Decision date: 2024-08-08. Results received: No. Last updated: 2026-07-09.
Decision dates by country: BE: 2024-08-08, AT: 2024-08-19, FR: 2024-09-09, IT: 2024-08-12, ES: 2024-08-12, DE: 2024-08-09

Condition(s): Neovascular Age-Related Macular Degeneration (nAMD)
Product: RO4893594, RO4893594, RANIBIZUMAB

Primary endpoint: 1. Incidence and severity of ocular and systemic (non-ocular) adverse events, 2. Incidence, severity, and duration of adverse event of special interest (AESIs), 3. Incidence, severity, and duration of ocular AESIs during the post operative period (up to 37 days of initial implantation) and follow up period (>37 days after implantation surgery) for patients who receive the implant in the study, 4. Incidence and severity of adverse device effects, 5. Incidence, causality, severity, and duration of anticipated serious adverse device effects
Endpoint(s): 1. Change in best-corrected visual acuity (BCVA) score from baseline over time, as assessed using the Early Treatment Diabetic Retinopathy Study (ETDRS) visual acuity chart at a starting distance of 4 meters, 2. Percentage of patients who lose < 15, < 10, or < 5 letters in BCVA score from baseline over time, 3. Percentage of patients with BCVA score of 38 letters (of 20/200 approximate Snellen equivalent) or worse over time, 4. Percentage of patients with BCVA score of 69 letters (20/40 approximate Snellen equivalent) or better over time, 5. Change from baseline in CPT over time, 6. Percentage of patients who undergo supplemental treatment with intravitreal ranibizumab 0.5 mg during each refill-exchange interval

Source: https://euclinicaltrials.eu/ctis-public/view/2023-507131-38-00